EU clinical trial 2024-517688-21-00: IMpAct of CardiolRxTM oVer 6 months following IL-1 Blocker cessation in pERICarditis patients – MAVERIC: A randomized, double-blind, placebo-controlled trial
Protocol code: 100-006
Sponsor: Cardiol Therapeutics Inc. (Pharmaceutical company). Phase: Therapeutic confirmatory (Phase III). Countries: Greece (ended), Italy (ended).
Therapeutic area(s): Diseases [C] - Cardiovascular Diseases [C14]
Gender: Female, Male. Age: 18-64 years, 65+ years. Enrolment: 54.
Status: Ended. Start date (EU): 2025-09-04. End date (EU): 2026-08-03. Decision date: 2025-04-30. Results received: No. Last updated: 2025-11-28.
Decision dates by country: GR: 2025-04-30, IT: 2025-04-30

Condition(s): Recurrent Pericarditis
Product: CardiolRx™ Placebo is a non-aqueous solution of medium chain triglycerides with 1.0% vitamin E as anti-oxidant. CardiolRx™ Placebo is a pale yellow clear liquid. The CardiolRx™ Placebo product is essentially the same as the CardiolRx™ drug product with the exception that the placebo does not include the active drug substance, cannabidiol., CardiolRx

Primary endpoint: The primary efficacy endpoint is the proportion of patients free from a new episode of recurrent pericarditis*, from the timepoint of stopping the IL-1 blocker to Visit 9 (Week 24)., * For the purpose of this trial, pericarditis recurrence is defined as the recurrence of typical pericarditis pain associated with supportive objective evidence of pericarditis (at least 1 day with pericarditis pain measurement ≥ 4 on the 11-point NRS AND a CRP value ≥ 1 mg/dL either on the same day or separated by no more than 7 days., Safety parameters include the number of AEs and SAEs, changes in C-SSRS and in laboratory parameters, including liver function parameters and INR, as well as ECG intervals and rhythm during the trial period. In addition, all patients will have Pharmocokinetic (PK) samples obtained according to the Schedule of Trial Procedures (see Section 20.2).
Endpoint(s): Exploratory efficacy endpoints include: - the restricted mean time to a new episode of pericarditis recurrence from the timepoint of stopping the IL-1 blocker to Visit 9 (Week 24) - the mean pain score using an 11-point NRS at Visit 6 (Week 8) and at Visit 9 (Week 24) (highest pain score recorded during the 7 days prior to Visit 6 and Visit 9) - the change in CRP from Visit 1 (Day 1) to Visit 6 (Week 8) and Visit 9 (Week 24), as measured by the central laboratory., The secondary efficacy endpoint is the percentage of days with no or minimal pericarditis pain as assessed by an NRS score ≤ 2 from the timepoint of stopping the IL-1 blocker to Visit 9 (Week 24).

Source: https://euclinicaltrials.eu/ctis-public/view/2024-517688-21-00